EU clinical trial 2022-502276-23-00: Randomized, open-label, multicenter phase 3 study to assess the efficacy and safety of GIVinostat versus hydroxyurea IN JAK2V617F-positive high-risk Polycythemia Vera patients: the GIV-IN PV TRIAL
Protocol code: DSC/08/2357/32
Sponsor: Italfarmaco S.p.A. (Pharmaceutical company). Phase: Therapeutic confirmatory (Phase III). Countries: Hungary (ongoing, recruiting), Poland (ongoing, recruiting), Italy (ongoing, recruiting), Spain (ongoing, recruiting), Bulgaria (ongoing, recruiting), Croatia (ongoing, recruiting), France (ongoing, recruiting), Austria (ongoing, recruiting), Netherlands (ongoing, recruiting), Germany (ongoing, recruiting), Ireland (ongoing, recruiting).
Therapeutic area(s): Diseases [C] - Hemic and Lymphatic Diseases [C15]
Gender: Female, Male. Age: 18-64 years, 65+ years. Enrolment: 219.
Status: Ongoing, recruiting. Start date (EU): 2024-04-25. Decision date: 2024-03-27. Results received: No. Last updated: 2026-04-01.
Decision dates by country: BG: 2024-04-04, IE: 2024-04-05, AT: 2024-04-08, FR: 2024-04-05, HU: 2024-03-28, IT: 2024-04-04, DE: 2024-03-28, ES: 2024-03-27, HR: 2024-04-04, PL: 2024-04-02, NL: 2024-04-08

Condition(s): JAK2V617F-positive high-risk Polycythemia Vera
Product: Givinostat 50 mg capsules, RIVAROXABAN, ACETYLSALICYLIC ACID, Givinostat 100 mg capsules, HYDROXYCARBAMIDE, ENOXAPARIN, Givinostat 75 mg capsules, DABIGATRAN ETEXILATE

Primary endpoint: Core treatment phase: Proportion of patients achieving a response at Week 48, with response assessment based on: • CHR defined as: HCT < 45% without phlebotomy in the previous 3 months, and WBC count ≤ 10 × 109/L, and PLT count ≤ 400 × 109/L and, • Normal spleen size as measured by imaging (i.e., MRI - recommended techique, or CT scan). Normal spleen size is defined as: a longitudinal diameter ≤ 12 cm for female and ≤ 13 cm for male, and, • From (Week 25 up to week 48), absence of: progressive disease (as defined in the revised ELN response criteria), major hemorrhagic events (as defined by the International Society on Thrombosis and Haemostasis) and major thrombotic events. Please refer to Protocol, section 3.1 for further details, Extended treatment phase: • Type, incidence and severity of TEAEs, including SAEs, TEAEs leading to discontinuation or deaths in eligible patients who continued in the extended treatment phase of the DSC/08/2357/32 study.
Endpoint(s): Proportion of patients achieving a complete hematological response (CHR) at Week 48 based on: – HCT < 45% without phlebotomy in the previous 3 months, and – White blood cell (WBC) count ≤ 10 × 109/L, and – PLT count ≤ 400 × 109/L Please refer to Protocol, section 3.2 for further details, Time from randomization to the first observed CHR Please refer to Protocol, section 3.2 for further details, Proportion of patients with a normal spleen size at Week 48, Safety and tolerability. Please refer to Protocol, section 3.2 for further details, Long-term efficacy evaluated as: - Proportion of patients with a response at yearly assessment visits. - Duration of first CHR. Please refer to Protocol, section 3.2 for further details, Efficacy evaluated as: - time from randomization to first HCT response without phlebotomy in the previous 3 months; - time from randomization to first WBC response; - time from randomization to first PLT response up to week 48 and in patients with impairment for each parameter at baseline. Please refer to Protocol, section 3.2 for further details., Changes from baseline in physical examination findings, Eastern Cooperative Oncology Group (ECOG) performance status and vital signs, electrocardiograms (ECGs) evaluations, serum chemistry, hematology, serology (if applicable) and urinalysis results. Please refer to Protocol, section 3.2 for further details

Source: https://euclinicaltrials.eu/ctis-public/view/2022-502276-23-00